EU clinical trial 2023-503731-18-00: An Open Label, Phase 1/2 Study of HST-1011 Given as Monotherapy and in Combination with an Anti-PD1 Antibody in Patients with Advanced Solid Tumors
Protocol code: Clin-001
Sponsor: Hotspot Therapeutics Inc. (Pharmaceutical company). Phase: Phase I and Phase II (Integrated)- First administration to humans. Countries: Spain (ended).
Therapeutic area(s): Diseases [C] - Neoplasms [C04]
Gender: Female, Male. Age: 18-64 years, 65+ years. Enrolment: 20.
Status: Ended. Start date (EU): 2024-09-30. End date (EU): 2025-05-28. End date: 2025-10-31. Decision date: 2023-10-19. Results received: Yes. Last updated: 2025-04-09.

Condition(s): Advanced Solid Tumors
Product: LIBTAYO 350 mg concentrate for solution for infusion., HST-1011 5mg, HST-1011 40mg, HST-1011 150mg, HST-1011 10mg

Primary endpoint: A1: Incidence of dose-limiting toxicities (DLTs), treatment-emergent adverse events (TEAEs), serious adverse events (SAEs), and changes between baseline and postbaseline laboratory assessments, electrocardiograms (ECGs), vital signs, and physical exams., A2: Integration of safety, PDc, PK, and preliminary efficacy endpoints, B1: Incidence of DLTs, TEAEs, SAEs, and changes between baseline and postbaseline laboratory assessments, electrocardiograms (ECGs), vital signs, and physical exams, B2: Integration of safety, PDc, PK, and preliminary efficacy endpoints
Endpoint(s): A1: PK parameters including but not limited to: maximum observed plasma concentration (Cmax), time of maximum observed plasma concentration (Tmax), area under the concentration-time curve from time 0 to time of last quantifiable concentration (AUC0-t) or in 1 dosing interval (AUCtau), concentration observed at trough (Ctrough, Ctau), A1: Summary measures of HST-1011 PK parameters after oral administration, A1: ORR per Investigator assessed Response Evaluation Criteria in Solid Tumors (RECIST) v1.1, A1: Peripheral blood cytokines / chemokines and changes in global gene expression profiles, A2: Incidence of TEAEs, SAEs, and changes between baseline and postbaseline laboratory assessments, electrocardiograms (ECGs), vital signs, and physical exams, A2: Summary measures of HST-1011 PK parameters after oral administration (single and multiple dose), A2: Peripheral blood cytokines / chemokines, immune cell numbers and phenotypes, and changes in global gene expression profiles, B1: PK parameters including but not limited to: Cmax, Tmax, AUC0-t, AUCtau, Ctrough, Ctau, B1: Summary measures of HST-1011 PK parameters after oral administration, B1: Peripheral blood cytokines / chemokines and changes in global gene expression profiles, B1: ORR per Investigator assessed RECIST v1.1, B2: Incidence of TEAEs, SAEs, and changes between baseline and postbaseline laboratory assessments, electrocardiograms (ECGs), vital signs, and physical exams, B2: Summary measures of HST-1011 PK parameters after oral administration (single and multiple dose), B2: Peripheral blood cytokines / chemokines, immune cell numbers and phenotypes, and changes in global gene expression profiles, A2: Investigator assessed: ORR, DOR, DCR, PFS and OS per RECIST v1.1 or PCWG3 criteria, as applicable, B2: Investigator assessed: ORR, DOR, DCR, PFS and OS per RECIST v1.1 or PCWG3 criteria, as applicable

Source: https://euclinicaltrials.eu/ctis-public/view/2023-503731-18-00